EU clinical trial 2023-508227-13-00: A phase 1/2 open-label, multicenter study to assess the safety, pharmacokinetics and anti-tumor activity of GTAEXS617 in patients with advanced solid tumors
Protocol code: GTAEXS617-001
Sponsor: Exscientia AI Limited (Pharmaceutical company). Phase: Phase I and Phase II (Integrated)- First administration to humans. Countries: Belgium (ongoing, recruiting).
Therapeutic area(s): Diseases [C] - Neoplasms [C04]
Gender: Female, Male. Age: 18-64 years, 65+ years. Enrolment: 112.
Status: Ongoing, recruiting. Start date (EU): 2023-06-19. Decision date: 2024-01-15. Results received: No. Last updated: 2026-06-30.

Condition(s): Advanced solid tumors
Product: Capecitabine Accord 150 mg film-coated tablets, Abevmy 25 mg/mL concentrate for solution for infusion., Paclitaxel Kabi 6 mg/ml Konzentrat zur Herstellung einer Infusionslösung, Paclitaxel Kabi 6 mg/ml Konzentrat zur Herstellung einer Infusionslösung, Paclitaxel Kabi 6 mg/ml Konzentrat zur Herstellung einer Infusionslösung, Paclitaxel Kabi 6 mg/ml Konzentrat zur Herstellung einer Infusionslösung, Fulvestrant Ribosepharm 250 mg Injektionslösung in einer Fertigspritze, Caelyx pegylated liposomal 2 mg/ml concentrate for solution for infusion, GTAEXS617, Fulvestrant Ribosepharm 250 mg Injektionslösung in einer Fertigspritze, Fulvestrant Ribosepharm 250 mg Injektionslösung in einer Fertigspritze, Caelyx pegylated liposomal 2 mg/ml concentrate for solution for infusion, Paclitaxel Kabi 6 mg/ml Konzentrat zur Herstellung einer Infusionslösung, GTAEXS617, Abevmy 25 mg/mL concentrate for solution for infusion., Capecitabine Accord 150 mg film-coated tablets, Paclitaxel Kabi 6 mg/ml Konzentrat zur Herstellung einer Infusionslösung, Capecitabine Accord 500 mg film-coated tablets, Paclitaxel Kabi 6 mg/ml Konzentrat zur Herstellung einer Infusionslösung, Capecitabine Accord 500 mg film-coated tablets, Abevmy 25 mg/mL concentrate for solution for infusion., Paclitaxel Kabi 6 mg/ml Konzentrat zur Herstellung einer Infusionslösung, Capecitabine Accord 500 mg film-coated tablets, Paclitaxel Kabi 6 mg/ml Konzentrat zur Herstellung einer Infusionslösung, Fulvestrant Ribosepharm 250 mg Injektionslösung in einer Fertigspritze, Capecitabine Accord 150 mg film-coated tablets, Abevmy 25 mg/mL concentrate for solution for infusion., GTAEXS617, Caelyx pegylated liposomal 2 mg/ml concentrate for solution for infusion, Capecitabine Accord 150 mg film-coated tablets, Caelyx pegylated liposomal 2 mg/ml concentrate for solution for infusion, Capecitabine Accord 500 mg film-coated tablets

Primary endpoint: Incidence of DLTs during Cycle 1 of treatment (Phase 1), Incidence and severity of AEs, SAEs and TEAEs; safety parameters variations from baseline (Phase 1), Tolerability – Frequency of dose interruptions, dose reductions and dose intensity achieved (Phase 1), ORR assessed using RECIST v1.1 (Phase 2), Safety - Incidence and severity of AEs, SAEs and TEAEs; safety parameters variations from baseline (Phase 2), Tolerability – Frequency of dose interruptions, dose reductions and dose intensity achieved (Phase 2), Adherence – treatment diary(Phase 2)
Endpoint(s): Plasma and urine GTAEXS617 PK parameters including but not limited to: • Cmax, tmax, AUC0-last, AUC(0-inf), AUC(0-tau), accumulation of Cmax (Rcmax) and AUC(0-tau) (RAUC(0-tau)), t1/2, CL/F, and Vz/F (Phase 1 and 2) • By-interval and cumulative GTAEXS617 excretion in urine (Ae and fe), and CLr, GTAEXS617 as monotherapy and in combination with SoC • Plasma GTAEXS617 PK concentrations and, if appropriate, plasma PK parameters DCR, PFS, and DOR, assessed using RECIST (Phase 1 and 2), ORR, according to RECIST v1.1 Phase 1 (monotherapy & combination):

Source: https://euclinicaltrials.eu/ctis-public/view/2023-508227-13-00